EU clinical trial 2024-514205-60-00: A Phase II, Open Label, Randomised, Multi-centre Study to Assess the Safety and Efficacy of Agents Targeting DNA Damage Repair in Combination with Olaparib versus Olaparib Monotherapy in the Treatment of Metastatic Triple Negative Breast Cancer Patients Stratified by Alterations in Homologous Recombinant Repair (HRR)-related Genes (including BRCA1/2) (VIOLETTE)
Protocol code: D5336C00001
Sponsor: AstraZeneca AB (Pharmaceutical company). Phase: Therapeutic exploratory (Phase II). Countries: Spain (ongoing, recruitment ended), Poland (ongoing, recruitment ended), Portugal (ended).
Therapeutic area(s): Diseases [C] - Neoplasms [C04]
Gender: Female, Male. Age: 18-64 years, 65+ years. Enrolment: 3.
Start date (EU): 2018-02-15. Decision date: 2024-08-21. Results received: No. Last updated: 2026-05-22.
Decision dates by country: PT: 2024-10-07, PL: 2024-10-02, ES: 2024-08-21

Condition(s): Triple Negative Breast Cancer
Product: AZD6738, Lynparza 100 mg film-coated tablets, Lynparza 150 mg film-coated tablets, Ceralasertib, AZD6738

Primary endpoint: Progression-free Survival Per Stratum (BICR)., Progression-free Survival Per Stratum (Sensitivity Analysis).
Endpoint(s): Progression-free Survival (Per BICR)., Number of Patients With Objective Response (Per BICR and Per Sensitivity Analysis)., Objective Response Rate (ORR) (Per BICR and Per Sensitivity Analysis), Duration of Response (DoR) [Per BICR and Per Sensitivity Analysis], Percentage Change From Baseline in Target Lesion Tumour Size [Per BICR and Per Sensitivity Analysis], Overall Survival (OS), Plasma Drug Concentrations of olaparib, Plasma Drug Concentrations of ceralasertib and adavosertib, Number of Patients With Treatment Emergent Adverse Events (TEAEs)

Source: https://euclinicaltrials.eu/ctis-public/view/2024-514205-60-00